EU clinical trial 2023-509461-20-00: A Randomized Controlled Phase II Clinical Trial with Intradermal IMO-2125 (Tilsotolimod) in clinical cT3-4N0M0 Melanoma (Intrim 1 study)
Sponsor: Amsterdam UMC (Hospital/Clinic/Other health care facility). Phase: Therapeutic exploratory (Phase II). Countries: Netherlands (ongoing, recruitment ended).
Therapeutic area(s): Diseases [C] - Neoplasms [C04]
Gender: Female, Male. Age: 18-64 years, 65+ years. Enrolment: 214.
Status: Ongoing, recruitment ended. Start date (EU): 2020-01-22. Decision date: 2024-12-06. Results received: No. Last updated: 2024-12-06.

Condition(s): pT3-4 cN0M0 Melanoma
Product: IMO-2125

Primary endpoint: The rate of tumor positive SLN seven days after the experimental treatment.
Endpoint(s): Frequency and activation state of lymph node resident (LNR) conventional dendritic cells (DC) and melanoma antigen-specific T cell responses in the SLN and peripheral blood., RFS at 18 months, 24 months, 36 months, 5 years and 10 years after SNB., OS at 18 months, 24 months, 36 months, 5 5 years and 10 years after SNB.

Source: https://euclinicaltrials.eu/ctis-public/view/2023-509461-20-00